EU clinical trial 2024-516575-32-00: A bioavailability study of epinephrine following a single dose of emergency response auto-injector in comparison to epinephrine injection into muscle via syringe in healthy adults.
Protocol code: EPIN-IJS-1002
Sponsor: Mylan Pharmaceuticals Inc. (Pharmaceutical company). Phase: Human Pharmacology (Phase I)- Other. Countries: Germany (ended).
Therapeutic area(s): Not possible to specify
Gender: Female, Male. Age: 18-64 years. Enrolment: 12.
Status: Ended. Start date (EU): 2025-01-10. End date (EU): 2025-05-16. End date: 2025-05-17. Decision date: 2024-12-05. Results received: No. Last updated: 2024-12-05.

Condition(s): Allergic reactions (Type 1), including anaphylaxis, idiopathic anaphylaxis or exercise-induced anaphylaxis

Source: https://euclinicaltrials.eu/ctis-public/view/2024-516575-32-00